EU clinical trial 2023-506499-29-00: A Phase 1b Study of Imvotamab in Severe Systemic Lupus Erythematosus
Protocol code: IGM-2323-101
Sponsor: IGM Biosciences Inc. (Pharmaceutical company). Phase: Human Pharmacology (Phase I)- Other. Countries: Poland (ended).
Therapeutic area(s): Diseases [C] - Immune System Diseases [C20]
Gender: Female, Male. Age: 18-64 years, 65+ years. Enrolment: 6.
Status: Ended. Start date (EU): 2024-02-28. End date (EU): 2025-01-27. End date: 2025-01-28. Decision date: 2024-01-22. Results received: No. Last updated: 2024-11-11.

Condition(s): Systemic Lupus Erythematosus

Source: https://euclinicaltrials.eu/ctis-public/view/2023-506499-29-00